EU clinical trial 2024-512573-27-01: A Phase 2, open-label, multi-centre, multi-national interventional trial to evaluate the efficacy and safety of erdafitinib (ERDA) monotherapy and erdafitinib (ERDA) and cetrelimab (CET) combination as neoadjuvant treatment in cisplatin-ineligible patients with muscle-invasive bladder cancer (MIBC) whose tumours express FGFR gene alterations (SOGUG-NEOWIN)
Protocol code: SOGUG2020IEC(VEJ)11
Sponsor: Grupo Espanol De Oncologia Genitourinaria-Socug (Patient organisation/association). Phase: Therapeutic exploratory (Phase II). Countries: Italy (ongoing, recruitment ended), Spain (ongoing, recruitment ended), France (ongoing, recruitment ended).
Therapeutic area(s): Diseases [C] - Neoplasms [C04]
Gender: Female, Male. Age: 18-64 years, 65+ years. Enrolment: 62.
Status: Ongoing, recruitment ended. Start date (EU): 2023-12-11. Decision date: 2024-08-07. Results received: No. Last updated: 2026-06-15.
Decision dates by country: FR: 2024-09-13, IT: 2024-08-13, ES: 2024-08-07

Condition(s): Muscle-invasive bladder cancer (MIBC)
Product: JNJ-42756493, JNJ-63723283, JNJ-42756493, JNJ-42756493

Primary endpoint: Pathological complete response (pCR), Pathological downstaging < ypT2
Endpoint(s): Rate of pathological downstaging (pDS), Event-free Survival rate, OS, ORR according to RECIST, after neoadjuvant treatment, Adverse events, Rate of delay of surgery (classed as a delay event if performed > 6 weeks after last dose of treatment)

Source: https://euclinicaltrials.eu/ctis-public/view/2024-512573-27-01